EU clinical trial 2023-503812-34-00: C5721001 - Open Label Phase 2 Study of Tisotumab Vedotin for Locally Advanced or Metastatic Disease in Solid Tumors
Protocol code: SGNTV-001
Sponsor: Seagen Inc. (Pharmaceutical company). Phase: Therapeutic exploratory (Phase II). Countries: Germany (ended), Italy (ended), France (ended), Spain (ongoing, recruitment ended).
Therapeutic area(s): Diseases [C] - Neoplasms [C04]
Gender: Female, Male. Age: 18-64 years, 65+ years. Enrolment: 79.
Start date (EU): 2019-02-13. Decision date: 2024-02-12. Results received: No. Last updated: 2026-05-22.
Decision dates by country: DE: 2024-05-17, IT: 2024-02-14, FR: 2024-02-16, ES: 2024-05-17

Condition(s): Locally Advanced or Metastatic Disease in Solid Tumors
Product: CISPLATIN, CARBOPLATIN, HuMax-TF-ADC, KEYTRUDA 25 mg/mL concentrate for solution for infusion

Primary endpoint: Parts A, B, C and E: o Investigator-determined confirmed ORR as measured by RECIST v.1.1, Part D, F and G: o Investigator-determined confirmed ORR as measured by RECIST v.1.1
Endpoint(s): Parts A, B, C and E: o Investigator-determined confirmed and unconfirmed ORR as measured by RECIST v.1.1 o Type, incidence, severity, seriousness, and relatedness of AEs, Part D, F and G: o Investigator-determined confirmed and unconfirmed ORR as measured by RECIST v.1.1 o Type, incidence, severity, seriousness, and relatedness of AEs, All parts of the Study: o Investigator-determined disease control rate (DCR) as measured by RECIST v1.1 o Investigator-determined time to response (TTR) as measured by RECIST v1.1 o Investigator-determined PFS as measured by RECIST v1.1 o Overall survival (OS) o Selected PK parameters for tisotumab vedotin, total antibody, MMAE o Incidence of anti-therapeutic antibodies (ATAs) to tisotumab vedotin

Source: https://euclinicaltrials.eu/ctis-public/view/2023-503812-34-00